EU clinical trial 2025-524125-40-01: Immune dynamics and biomarkers of anti-tumor response in BMS-986340 (anti-CCR8) and nivolumab (anti-PD-1) co-treatment of metastatic tumors
Protocol code: ONC-2025-001
Sponsor: Humanitas Mirasole S.p.A., Fondazione Humanitas Per La Ricerca Ets (Hospital/Clinic/Other health care facility, Patient organisation/association). Phase: Therapeutic exploratory (Phase II). Countries: Italy (authorised, recruitment pending).
Therapeutic area(s): Diseases [C] - Neoplasms [C04]
Gender: Female, Male. Age: 18-64 years, 65+ years. Enrolment: 30.
Status: Authorised, recruitment pending. Decision date: 2026-07-23. Results received: No. Last updated: 2026-07-23.

Condition(s): Metastatic solid tumors, with the following specific indications: Non–Small Cell Lung Cancer (NSCLC), metastatic, PD-(L)1–refractory/resistant Gastric adenocarcinoma, metastatic, PD-(L)1–refractory/resistant Colorectal cancer (microsatellite stable, MSS), metastatic, immunotherapy‑naïve Pancreatic adenocarcinoma, metastatic, immunotherapy‑naïve
Product: Anti-CCR8 NF mAb, OPDIVO 10 mg/mL concentrate for solution for infusion., OPDIVO 10 mg/mL concentrate for solution for infusion., OPDIVO 10 mg/mL concentrate for solution for infusion., OPDIVO 10 mg/mL concentrate for solution for infusion.

Primary endpoint: Identification of circulating and tissue biomarkers (mediators of inflammation, key immune populations, specific gene expression patterns) induced by combination treatment. We will monitor immune responses longitudinally in the peripheral blood and at multiple tissue sites (tumor, LNs, skin) to investigate immune changes induced by combination treatment, Disease control rate (DCR) defined as the proportion of patients who achieve complete response (CR), partial response (PR), or stable disease (SD) as their best overall response to treatment, according to RECIST 1.1 by investigator assessment
Endpoint(s): Identification of circulating and tissue biomarkers (mediators of inflammation, key immune populations, specific gene expression patterns) that are differentially occurring in responders vs. non-responders to combination treatment (for exploratory purposes only)., Objective response and duration of response (DOR), defined as defined as the time from the first documentation of objective response (complete response [CR] or partial response [PR]) to the first documentation of disease progression or death from any cause, whichever occurs first; progression-free survival (PFS); overall survival (OS) ., Safety assessment

Source: https://euclinicaltrials.eu/ctis-public/view/2025-524125-40-01